EU clinical trial 2023-510022-33-00: Phase 3 Double-Blind Multicenter Randomized Active-Controlled Study to Evaluate the Safety and Efficacy of Bictegravir/Lenacapavir Versus Biktarvy® (Bictegravir/ Emtricitabine/Tenofovir Alafenamide) in Virologically Suppressed People with HIV-1
Protocol code: GS-US-621-6290
Sponsor: Gilead Sciences Inc. (Pharmaceutical company). Phase: Therapeutic confirmatory (Phase III). Countries: France (ended), Spain (ongoing, recruitment ended), Italy (ongoing, recruitment ended), Germany (ongoing, recruitment ended).
Therapeutic area(s): Diseases [C] - Virus Diseases [C02]
Gender: Female, Male. Age: 18-64 years, 65+ years. Enrolment: 120.
Start date (EU): 2024-10-03. Decision date: 2024-07-09. Results received: No. Last updated: 2025-12-05.
Decision dates by country: FR: 2024-10-01, DE: 2024-10-01, ES: 2024-07-11, IT: 2024-07-09

Condition(s): HIV-1 infection
Product: PTM 300 mg tablets, Biktarvy 50 mg/200 mg/25 mg film-coated tablets, PTM 75/50 mg FDC tablets, Sunlenca 300 mg film-coated tablets, BICTEGRAVIR 75 MG/LENACAPAVIR 50 MG FDC TABLETS, PTM 50/200/25 mg FDC tablets

Primary endpoint: Proportion of participants with HIV-1 RNA ≥ 50 copies/mL at Week 48 as determined by the United States (US) Food and Drug Administration (FDA)–defined snapshot algorithm.
Endpoint(s): Proportion of participants with HIV-1 RNA < 50 copies/mL at Week 48 as determined by the US FDA-defined snapshot algorithm, Change from baseline in CD4 cell count at Week 48, Proportion of participants from Treatment Group 1 with HIV-1 RNA ≥ 50 copies/mL at Week 96 (96 weeks on BIC/LEN including blinded and open-label [OL] phases) as determined by US FDA–defined snapshot algorithm, Proportion of participants from Treatment Group 1 with HIV-1 RNA < 50 copies/mL at Week 96 (96 weeks on BIC/LEN including blinded and OL phases) as determined by US FDA–defined snapshot algorithm, Change from baseline in CD4 cell count at Week 96 for participants from Treatment Group 1 (96 weeks on BIC/LEN including blinded and OL phases), Proportion of participants experiencing treatment-emergent adverse events (AEs) through Week 48, Proportion of participants from Treatment Group 1 experiencing treatment-emergent AEs through Week 96 (96 weeks on BIC/LEN including blinded and OL phases)

Source: https://euclinicaltrials.eu/ctis-public/view/2023-510022-33-00